EU clinical trial 2025-520654-10-00: A study in healthy people to test how itraconazole influences the amount of BI 3031185 in the blood
Protocol code: 1516-0004
Sponsor: Boehringer Ingelheim International GmbH (Pharmaceutical company). Phase: Human Pharmacology (Phase I)- Other. Countries: Germany (ended).
Therapeutic area(s): Not possible to specify
Gender: Male. Age: 18-64 years. Enrolment: 14.
Status: Ended. Start date (EU): 2025-10-06. End date (EU): 2026-01-21. Decision date: 2025-08-12. Results received: No. Last updated: 2025-08-12.

Condition(s): Healthy volunteer trial

Source: https://euclinicaltrials.eu/ctis-public/view/2025-520654-10-00